EU clinical trial 2023-508425-28-00: Phase 2/3, Multistage, Multicenter, Randomized, Double-Blind, Placebo-Controlled Parallel Group Withdrawal Study to Evaluate the Efficacy and Safety of Nipocalimab Administered to Adults with Chronic Inflammatory Demyelinating Polyneuropathy (CIDP)
Protocol code: 80202135CDP3001
Sponsor: Janssen Cilag International (Pharmaceutical company). Phase: Therapeutic exploratory (Phase II). Countries: Italy (ongoing, recruiting), Greece (ongoing, recruiting), Czechia (ongoing, recruiting), Poland (ongoing, recruiting), Germany (ongoing, recruiting), France (ongoing, recruiting), Spain (ongoing, recruiting), Portugal (ongoing, recruiting).
Therapeutic area(s): Diseases [C] - Nervous System Diseases [C10]
Gender: Female, Male. Age: 18-64 years, 65+ years. Enrolment: 85.
Status: Ongoing, recruiting. Start date (EU): 2022-10-24. Decision date: 2024-05-13. Results received: No. Last updated: 2026-06-05.
Decision dates by country: PT: 2024-05-13, FR: 2024-06-11, GR: 2024-06-10, IT: 2024-05-29, DE: 2024-05-21, PL: 2024-05-13, CZ: 2024-05-14, ES: 2024-05-13

Condition(s): Chronic Inflammatory Demyelinating Polyneuropathy
Product: Privigen 100 mg/ml solution for infusion, Saline, 0.9% Sodium Chloride Solution for Injection, JNJ-80202135, JNJ-80202135

Primary endpoint: Time to first occurrence of a relapse event, where relapse is defined by the deterioration in either adjusted INCAT disability score relative to Stage B baseline or the switch to IVIg or other SoC as a result of investigator-assessed lack of efficacy as confirmed by an independent RAC
Endpoint(s): Time to initial confirmed ECI, Percentage of responders as determined by ECI, Change from Stage A baseline over time in adjusted INCAT disability score, Change from Stage A baseline over time in MRC Muscle Grading Scale Sum score, Change from Stage A baseline over time in I-RODS centile score, Change from Stage A baseline over time in mean grip strength (dominant hand), Change from Stage A baseline over time in mean grip strength (non-dominant hand), Time to first adjusted INCAT disability score deterioration relative to Stage B baseline, Time to first switch to IVIg or other SoC as a result of investigator-assessed lack of efficacy as confirmed by an independent RAC relative to Stage B baseline, Change from Stage B baseline over time in adjusted INCAT disability score, Change from Stage B baseline over time in MRC Muscle Grading Scale Sum score, Change from Stage B baseline over time in I-RODS centile score, Change from Stage B baseline over time in mean grip strength (dominant hand), Change from Stage B baseline over time in mean grip strength (non-dominant hand), Binary response endpoint satisfying all 4 conditions: (1) an improved adjusted INCAT disability score compared to Stage B baseline, (2) not relapsing, (3) not switching to SoC, (4) not discontinuing treatment, Percentage of participants with TEAEs and SAEs, Change in ECG, vital signs and clinical laboratory values over time, Incidence of clinically significant ECG, vital signs and clinical laboratory abnormalities, Percentage of participants with suicidal ideation or suicidal behavior based on the C-SSRS, Serum nipocalimab concentrations over time in participants receiving active study intervention, Incidence and titers of ADA to nipocalimab and the presence of NAb to nipocalimab, Changes in total serum IgG concentrations over time

Source: https://euclinicaltrials.eu/ctis-public/view/2023-508425-28-00